EU clinical trial 2023-506725-11-00: INFINITY - Effect of interferon gamma as a treatment for post-aggressive immunosuppression in intensive care units, a randomized Bayesian double-blind controlled trial versus placebo
Protocol code: APHP220672
Sponsor: Assistance Publique Hopitaux De Paris (Hospital/Clinic/Other health care facility). Phase: Therapeutic confirmatory (Phase III). Countries: France (ongoing, recruiting).
Therapeutic area(s): Diseases [C] - Immune System Diseases [C20]
Gender: Female, Male. Age: 18-64 years, 65+ years. Enrolment: 170.
Status: Ongoing, recruiting. Start date (EU): 2026-02-24. Decision date: 2024-10-01. Results received: No. Last updated: 2025-10-24.

Condition(s): Post-aggressive immunosuppression
Product: IMUKIN 2 X 106 UI (0,1 mg), solution injectable, SODIUM CHLORIDE

Primary endpoint: Number of days alive without mechanical ventilation on day 28 after randomization or on discharge from intensive care if this occurs before the 28th day
Endpoint(s): Evolution and kinetics of mHLA-DR measured at D0, D1, D2, D3, D7 and D28 or at discharge from intensive care if earlier (D0 corresponding to the day of inclusion in the study) between patients treated with recombinant interferon gamma 1-b versus placebo, Evolution and kinetics of inflammation markers (IL-1, IL-2, IL-6, IL-8, TNFa, etc.) measured in plasma at D0, D3 and D7, or at discharge from intensive care if it occurs before (D0 corresponding to the day of inclusion in the study) between patients treated with recombinant interferon gamma 1-b versus placebo., Mortality rate at D28 and D90 after randomization between patients treated with recombinant interferon gamma 1-b versus placebo, The incidence of nosocomial infections during an ICU stay between patients treated with recombinant interferon gamma 1-b versus placebo, Number of days alive without antibiotic assessed on day 28 after randomization between patients treated with recombinant interferon gamma 1-b versus placebo, Number of antibiotic-free days at 28 days after randomization, Kinetics of SOFA score assessed at inclusion and during the 7 days following inclusion between patients treated with recombinant interferon gamma 1-b versus placebo, Evolution and kinetics of lymphocyte count measured on D0, D1, D2, D3, D7 and D28 or upon discharge from intensive care if this occurs earlier (D0 corresponding to the day of inclusion in the study) between patients who received recombinant interferon gamma-1b compared with placebo., Changes in the transcriptome profile of circulating PBMC using scRNAseq analysis measured at D0, D3 and D7 or at discharge from intensive care if earlier.

Source: https://euclinicaltrials.eu/ctis-public/view/2023-506725-11-00